EU clinical trial 2022-501523-24-00: A Randomized, Blinded, Placebo Controlled, Phase 2a Proof-of-Concept Study to Evaluate Efficacy, Safety, and Tolerability of GS-5718 in Participants with Cutaneous Lupus Erythematosus (CLE)
Protocol code: GS-US-497-6486
Sponsor: Gilead Sciences Inc. (Pharmaceutical company). Phase: Therapeutic exploratory (Phase II). Countries: Czechia (ended), Germany (ended), Spain (ended).
Therapeutic area(s): Diseases [C] - Skin and Connective Tissue Diseases [C17]
Gender: Female, Male. Age: 18-64 years, 65+ years. Enrolment: 20.
Status: Ended. Start date (EU): 2023-10-12. End date (EU): 2026-01-14. End date: 2026-01-15. Decision date: 2023-09-25. Results received: No. Last updated: 2025-07-16.
Decision dates by country: CZ: 2023-09-26, DE: 2023-09-25, ES: 2023-09-26

Condition(s): Cutaneous Lupus Erythematosus (CLE)
Product: GS-5718 film-coated tablets 15mg, PTM GS-5718

Primary endpoint: Percent change from baseline in Cutaneous Lupus Erythematosus Disease Area and Severity Index activity (CLASI-A) score at Week 12.
Endpoint(s): Proportion of participants with Cutaneous Lupus Activity Investigator Global Assessment (CLA-IGA) score of 0 or 1 at Week 12., Incidence of treatment-emergent adverse events (TEAEs)., Incidence of treatment-emergent serious adverse events (TESAEs)., Incidence of treatment-emergent laboratory abnormalities., PK characteristics of GS-5718

Source: https://euclinicaltrials.eu/ctis-public/view/2022-501523-24-00